EU clinical trial 2025-524021-41-00: A Phase IV, open label, single arm trial to assess the safety and immunogenicity of BIMERVAX® LP.8.1 against SARS-CoV-2 variants.
Protocol code: HIPRA-HH-17
Sponsor: Hipra Scientific S.L. (Pharmaceutical company). Phase: Therapeutic use (Phase IV). Countries: Spain (ended).
Therapeutic area(s): Diseases [C] - Virus Diseases [C02]
Gender: Female, Male. Age: 65+ years. Enrolment: 68.
Status: Ended. Start date (EU): 2025-10-28. End date (EU): 2026-01-08. Decision date: 2025-10-27. Results received: No. Last updated: 2025-12-10.

Condition(s): COVID-19
Product: BIMERVAX LP.8.1 emulsion for injection COVID-19 Vaccine (recombinant, adjuvanted)

Primary endpoint: Number, percentage, and characteristics of solicited local reactions and systemic events through Day 7 after vaccination., Number, percentage, and characteristics of unsolicited adverse events (AEs) through the end of the study., Number and percentage of serious adverse events (SAEs) through the end of the study., Number and percentage of adverse events of special interest (AESIs) through the end of the study., Number and percentage of related medical attended adverse events (MAAEs) through the end of the study., Neutralisation titres against Omicron LP.8.1 and other SARS-CoV-2 variants, measured as inhibitory concentration 50 (IC50) by pseudovirion-based neutralisation assay (PBNA) and reported as reciprocal concentration for each individual sample and geometric mean titre (GMT), at Baseline and at Day 14., Geometric mean fold rise (GMFR) in neutralising antibody titres against Omicron LP.8.1 and other SARS-CoV-2 variants for descriptive analysis from Baseline to Day 14.
Endpoint(s): Binding antibody titres measured by an electrochemiluminescence immunoassay (ECLIA) for each individual sample and GMT at Baseline and at Day 14., Percentage of participants experiencing an increase of ≥ 2-fold in total binding antibody titres against SARS-CoV-2 measured by ECLIA from Baseline to Day 14.

Source: https://euclinicaltrials.eu/ctis-public/view/2025-524021-41-00